EU clinical trial 2024-519929-38-00: – IKF/AIO-QUINTIS – A Randomized Phase II Trial Evaluating Fruquintinib in Combination with Tislelizumab in Microsatellite Stable / Proficient Mismatch Repair (MSS/pMMR) Metastatic Colorectal Cancer without Active Liver Metastases
Protocol code: QUINTIS
Sponsor: Frankfurter Institut Fuer Klinische Krebsforschung IKF GmbH (Pharmaceutical company). Phase: Therapeutic exploratory (Phase II). Countries: Germany (ongoing, recruiting), Austria (ongoing, recruiting).
Therapeutic area(s): Diseases [C] - Neoplasms [C04]
Gender: Female, Male. Age: 18-64 years, 65+ years. Enrolment: 140.
Status: Ongoing, recruiting. Start date (EU): 2025-10-27. Decision date: 2025-06-11. Results received: No. Last updated: 2026-06-08.
Decision dates by country: AT: 2025-06-11, DE: 2025-06-11

Condition(s): Metastatic Colorectal Cancer without liver metastases
Product: Lonsurf 15 mg/6.14 mg film-coated tablets, Avastin 25 mg/ml concentrate for solution for infusion., Tevimbra 100 mg concentrate for solution for infusion, FRUZAQLA 1 mg hard capsules, FRUZAQLA 5 mg hard capsules

Primary endpoint: Progression-free survival (PFS), defined as time from randomization until date of progression acc. to RECIST v1.1 or death due to any cause.
Endpoint(s): Overall survival (OS), defined as time from randomization until date of death due to any cause., Objective response rate (ORR), defined as proportion of patients achieving complete or partial response (CR/PR) acc. to RECIST v1.1., Disease control rate (DCR), defined as proportion of patients achieving CR, PR, or stable disease (SD) acc. to RECIST v1.1., Duration of response (DoR), defined as time from response initiation (when either CR or PR is first determined) to disease progression acc. to RECIST v1.1 or death due to any cause., Assessment of safety of the treatment as determined by the incidence, nature, causality, frequency, timing, and severity of adverse events using NCI CTCAE v5.0., Assessment of HRQoL during treatment and follow-up using EORTC QLQ C30 and EQ-5D-5L questionnaires.

Source: https://euclinicaltrials.eu/ctis-public/view/2024-519929-38-00